EU clinical trial 2024-516432-94-00: Remimazolam versus Midazolam for sedation during upper GI endoscopy: a randomized controlled trial
Sponsor: Sint Antonius Ziekenhuis Stichting (Hospital/Clinic/Other health care facility). Phase: Therapeutic use (Phase IV). Countries: Netherlands (ongoing, recruiting).
Therapeutic area(s): Diseases [C] - Digestive System Diseases [C06]; Analytical, Diagnostic and Therapeutic Techniques and Equipment [E] - Anesthesia and Analgesia [E03]
Gender: Female, Male. Age: 18-64 years, 65+ years. Enrolment: 148.
Status: Ongoing, recruiting. Start date (EU): 2024-10-21. Decision date: 2024-09-05. Results received: No. Last updated: 2024-09-05.

Product: Midazolam Viatris 1 mg/ml oplossing voor injectie, Byfavo 20 mg powder for solution for injection

Primary endpoint: Time to full alertness, defined as the time interval from the last dosage of the sedative and full alertness. Full alertness is evaluated using the well-known and validated MOAA/S score. This score is developed and validated to measure the level of alertness in subjects who are sedated.(16) Full alertness is defined as the first of 3 consecutive MOAA/S scores of at least 5.(16) The MOAA/S score is described in Appendix I.
Endpoint(s): Time interval between patient arrival in the recovery room and full alertness., Time to readiness for discharge, defined as the time interval from the last dosage of the sedative to readiness for discharge. Readiness for discharge is evaluated using the well-known and validated Aldrete score. This score is developed to measure when the patient recovery is sufficient for the patient to be discharged home. Readiness for discharge is defined as the first Aldrete score of at least 9.(17) The Aldrete score is described in Appendix II., Patients satisfaction is scored using two different parts of a questionnaire modified from the patient satisfaction with sedation instrument (PSSI). The PSSI is a validated score of procedural sedation satisfaction for outpatient endoscopies.(18) The complete PSSI includes 20 multiple choice type questions which are categorised into 4 sub-scales for describing a patient’s satisfaction. In this study we focused on the PSSI sub-scores for global satisfaction and procedural recall in a modified PSS, Endoscopist satisfaction is scored by the endoscopist directly after the procedure (range 0-10, with 0 being the lowest score, and 10 the highest)., Post-sedation amnesia is scored using a self-developed amnesia test. The test is described in Appendix IV., The success rate of sedation, defined as the percentage of procedures which will be finished as intended without requirement of > 5 boluses of midazolam and remimazolam, and without requirement for an alternative sedative., Incidence of adverse events related to midazolam and remimazolam.

Source: https://euclinicaltrials.eu/ctis-public/view/2024-516432-94-00